EU clinical trial 2023-506581-31-00: A Phase 1/2, First-in-Human Study of theMenin-KMT2A (MLL1)Inhibitor Bleximenib in Participants with Acute Leukemia
Protocol code: 75276617ALE1001
Sponsor: Janssen - Cilag International (Pharmaceutical company). Phase: Human Pharmacology (Phase I)- First administration to humans. Countries: France (ongoing, recruiting), Spain (ongoing, recruiting), Belgium (authorised, recruiting), Netherlands (not authorised).
Therapeutic area(s): Diseases [C] - Neoplasms [C04]
Gender: Female, Male. Age: 0-17 years, 18-64 years, 65+ years. Enrolment: 86.
Start date (EU): 2021-06-15. Decision date: 2023-11-02. Results received: No. Last updated: 2026-01-20.
Decision dates by country: BE: 2025-07-01, FR: 2023-11-07, ES: 2023-11-02

Condition(s): Acute Leukemia
Product: JNJ-75276617 (G010), JNJ-75276617 (G001), JNJ-75276617, JNJ-75276617 (G022), JNJ-75276617, JNJ-75276617 (G002), JNJ-75276617 (G007), JNJ-75276617 (G008), JNJ-75276617, JNJ-75276617, JNJ-75276617 (G003), JNJ-75276617 (G021), JNJ-75276617 (G011), JNJ-75276617 (G016), JNJ-75276617 (G024), JNJ-75276617 (G023)

Primary endpoint: Phase 1: Part 1 (Dose Escalation): Incidence and severity of adverse events, including dose-limiting toxicity, Phase 1: Part 2 (Dose Expansion): Incidence and severity of adverse events, Phase 2: Rate of CR/CRh assessed by the IRC.

Source: https://euclinicaltrials.eu/ctis-public/view/2023-506581-31-00